EU clinical trial 2025-524935-38-00: An open label, balanced, randomized, two-treatment, two-period, two-sequence, single-dose, crossover, bioequivalence study comparing Imatinib Mesylate Tablets 400 mg, manufactured by Sun Pharmaceutical Industries Limited, India with Glivec® (Imatinib mesylate) Coated tablets 400 mg, Produced by Novartis Pharma Produktions GmbH, Wehr, Germany or Novartis Pharmaceutical Manufacturing LLC, Ljubljana; Imported and Registered by Novartis Biosciences SA, Prof. Vicente Rao Avenue, 90, Sao Paulo – SP, CNPJ: 56.994.502/0001-30, Brazilian Industry, in healthy adult, human subjects under fed condition.
Protocol code: IMATI-10-25
Sponsor: Sun Pharmaceutical Industries Limited (Pharmaceutical company). Phase: Human Pharmacology (Phase I)- Bioequivalence Study. Countries: Romania (authorised, recruitment pending).
Therapeutic area(s): Diseases [C] - Neoplasms [C04]
Gender: Female, Male. Age: 18-64 years. Enrolment: 28.
Status: Authorised, recruitment pending. Decision date: 2026-05-05. Results received: No. Last updated: 2026-05-05.

Condition(s): Acute Lymphoblastic Leukemia (Ph+ ALL), (Ph+) Chronic Myeloid Leukemia

Source: https://euclinicaltrials.eu/ctis-public/view/2025-524935-38-00